EU clinical trial 2023-507350-33-00: An open-label study for participants who are non-responders at the end of treatment assessment on the VRDN-001-101 and VRDN-001-301 pivotal studies
Protocol code: VRDN-001-302
Sponsor: Viridian Therapeutics Inc. (Pharmaceutical company). Phase: Therapeutic confirmatory (Phase III). Countries: Czechia (ended), Italy (ended), Spain (ended), France (ended), Germany (ended), Netherlands (ended), Poland (ended), Hungary (ended).
Therapeutic area(s): Diseases [C] - Eye Diseases [C11]
Gender: Female, Male. Age: 18-64 years, 65+ years. Enrolment: 76.
Status: Ended. Start date (EU): 2024-06-25. End date (EU): 2025-06-04. End date: 2025-06-23. Decision date: 2024-04-16. Results received: Yes. Last updated: 2025-05-16.
Decision dates by country: CZ: 2024-04-17, NL: 2024-04-22, FR: 2024-04-16, IT: 2024-04-17, DE: 2024-04-17, PL: 2024-04-22, HU: 2024-07-16, ES: 2024-04-16

Condition(s): Thyroid eye disease
Product: Sodium Chloride 0.9% Intravenous Infusion, VRDN-001 (Insulin-like growth factor-1 receptor [IGF-1R] inhibitor)

Primary endpoint: Overall Responder Rate comprised of Proptosis Responder Rate in the most proptotic eye (i.e., reduction of proptosis of ≥ 2 mm from baseline [without a corresponding increase of ≥ 2 mm in the other eye]) at 3 weeks post the fifth IV infusion (i.e., Week 15) and Clinical Activity Responder Rate in the most proptotic eye (i.e., no worsening in CAS from baseline [without a corresponding increase of ≥2 points in the other eye]) at 3 weeks post the fifth IV infusion (i.e., Week 15), Safety Endpoints: Adverse Events (AEs) and Serious Adverse Events (SAEs) will be monitored and recorded throughout the duration of the study. All clinically significant changes in other safety assessments will be recorded as AEs.
Endpoint(s): Change from baseline in proptosis in the most proptotic eye at Week 15, Proptosis Responder Rate in the most proptotic eye as measured by exophthalmometer at Week 15., Change from baseline in proptosis in the most proptotic eye as measured by exophthalmometer at Week 15.

Source: https://euclinicaltrials.eu/ctis-public/view/2023-507350-33-00